EU clinical trial 2023-504522-19-00: Brightline-4: A Phase III open-label, single-arm, multi-center study to assess the safety and efficacy of brigimadlin (BI 907828) treatment in patients with treatment-naïve or pre-treated advanced dedifferentiated liposarcoma
Protocol code: 1403-0019
Sponsor: Boehringer Ingelheim International GmbH (Industry). Phase: Therapeutic confirmatory (Phase III). Countries: Belgium (ended), Italy (ended).
Therapeutic area(s): Diseases [C] - Neoplasms [C04]
Gender: Female, Male. Age: 18-64 years, 65+ years. Enrolment: 70.
Status: Ended. End date (EU): 2024-12-11. End date: 2025-12-12. Decision date: 2024-05-02. Results received: No. Last updated: 2024-12-10.
Decision dates by country: IT: 2024-05-02, BE: 2024-05-03

Condition(s): dedifferentiated liposarcoma
Product: BI 907828, BI 907828, BI 907828

Primary endpoint: Occurrence of TEAEs according to CTCAE version 5 during the entire treatment period, Occurrence of TEAEs with Grade ≥3 according to CTCAE version 5 during the entire treatment period
Endpoint(s): Occurrence of treatment-emergent serious adverse events (SAEs), Occurrence of TEAEs leading to study treatment discontinuation, Occurrence of TEAEs leading to dose reduction, Occurrence of TEAEs leading to dose delay, Occurrence of TEAEs of special interest (adverse events of special interest [AESIs]), Objective response: OR is defined as a best overall response of confirmed complete response (CR) or confirmed PR according to Response Evaluation Criteria In Solid Tumours (RECIST) version 1.1 (based on investigator assessment) from the date of treatment start until the earliest date of disease progression, death, or last evaluable tumour assessment before start of subsequent anticancer therapy, lost to follow-up, or withdrawal of consent, Progression-free survival: PFS is defined as the time from treatment start until the earliest date of tumour progression according to RECIST version 1.1, based on investigator assessment, or death from any cause, Overall survival: OS is defined as the time from treatment start until death from any cause, Duration of objective response: DOR is defined as the time from first documented confirmed OR until the earliest date of disease progression or death among patients with confirmed OR (based on investigator assessment), Disease control (DC): DC is defined as a best overall response of CR, PR, or SD where best overall response is defined according to RECIST version 1.1 based on investigator assessment

Source: https://euclinicaltrials.eu/ctis-public/view/2023-504522-19-00